EU clinical trial 2024-514302-31-00: Investigation of 3 different doses of a newly developed vaginal ring releasing estriol for the treatment of vaginal atrophy - a placebo-controlled, double-blind, combined dose-finding and proof-of-concept trial with parallel-group design in postmenopausal women
Protocol code: 1452est24ct
Sponsor: SocraTec R&D Concepts in Drug Research and Development GmbH (Pharmaceutical company). Phase: Therapeutic exploratory (Phase II). Countries: Germany (ended).
Therapeutic area(s): Diseases [C] - Female Urogenital Diseases and Pregnancy Complications [C13]
Gender: Female. Age: 18-64 years, 65+ years. Enrolment: 112.
Status: Ended. Start date (EU): 2025-07-16. End date (EU): 2026-06-01. Decision date: 2025-06-16. Results received: No. Last updated: 2026-02-18.

Condition(s): Vaginal atrophy
Product: VR 102 (20 µg/day), Placebo vaginal ring without active drug, VR 102 (1 µg/day), VR 102 (10 µg/day)

Primary endpoint: Change from baseline in vaginal Maturation Value (MV) after 90 days of treatment, Change from baseline in % of vaginal superficial cells after 90 days of treatment, Change from baseline in % of vaginal parabasal cells after 90 days of treatment, Change from baseline in vaginal pH after 90 days of treatment, Proportion of responders with a vaginal pH ≤ 5 after 90 days of treatment, Total (AUC) E3 exposure over the course of treatment

Source: https://euclinicaltrials.eu/ctis-public/view/2024-514302-31-00